EU clinical trial 2026-525621-20-00: A Phase 1 Study of LBL-051 in Patients with Refractory Autoimmune Disease
Protocol code: LBL-051-101
Sponsor: Oblenio Bio Inc. (Pharmaceutical company). Phase: Human Pharmacology (Phase I)- First administration to humans. Countries: Germany (ongoing, recruiting).
Therapeutic area(s): Phenomena and Processes [G] - Immune system processes [G12]
Gender: Female, Male. Age: 18-64 years, 65+ years. Enrolment: 45.
Status: Ongoing, recruiting. Start date (EU): 2026-07-08. Decision date: 2026-06-25. Results received: No. Last updated: 2026-07-21.

Condition(s): B-cell–mediated autoimmune diseases

Source: https://euclinicaltrials.eu/ctis-public/view/2026-525621-20-00